EU clinical trial 2024-516844-25-01: REVOLUTION - Randomized phasE 2 study of Valproic acid in combination with bevacizumab and Oxaliplatin/fLUoropyrimidine regimens in patients with ras-mutated metastaTIc cOlorectal caNcer
Sponsor: IRCCS Istituto Nazionale Tumori Fondazione Pascale (Hospital/Clinic/Other health care facility). Phase: Therapeutic exploratory (Phase II). Countries: Italy (ongoing, recruitment ended).
Therapeutic area(s): Diseases [C] - Neoplasms [C04]
Gender: Female, Male. Age: 18-64 years, 65+ years. Enrolment: 200.
Status: Ongoing, recruitment ended. Start date (EU): 2019-01-03. Decision date: 2024-12-09. Results received: No. Last updated: 2026-06-09.

Condition(s): Patients with ras-mutated metastatIc colorectal cancer
Product: ACIDO VALPROICO E SODIO VALPROATO ratiopharm 500 mg compresse a rilascio prolungato, Capecitabina Glenmark 150 mg comprimidos recubiertos con película EFG, FLUOROURACILE PFIZER 50 mg/mL, solution à diluer pour perfusion, Avastin 25 mg/ml concentrate for solution for infusion., Oxaliplatino Accord 5 mg/ml concentrato per soluzione per infusione

Primary endpoint: PFS progression-free survival
Endpoint(s): centrally reviewed PFS (CR-PFS)

Source: https://euclinicaltrials.eu/ctis-public/view/2024-516844-25-01